EU clinical trial 2023-506046-24-00: A Phase 2 Long-Term Extension (LTE) Study to Evaluate The Safety and Efficacy of Efavaleukin Alfa in Subjects With Moderately to Severely Active Ulcerative Colitis
Protocol code: 20210210
Sponsor: Amgen Inc. (Pharmaceutical company). Phase: Therapeutic exploratory (Phase II). Countries: Austria (ended), Denmark (ended), Finland (ended), Slovakia (ended), Italy (ended), Romania (ended), Hungary (ended), Spain (ended), Belgium (ended), Poland (ended), Germany (ended), France (ended), Bulgaria (ended), Czechia (ended), Greece (ended), Latvia (ended), Netherlands (ended).
Therapeutic area(s): Diseases [C] - Digestive System Diseases [C06]
Gender: Female, Male. Age: 18-64 years, 65+ years. Enrolment: 70.
Status: Ended. Start date (EU): 2023-07-03. End date (EU): 2024-08-27. Decision date: 2024-05-31. Results received: Yes. Last updated: 2024-07-15.
Decision dates by country: AT: 2024-05-31, BE: 2024-06-03, BG: 2024-06-13, CZ: 2024-06-04, DK: 2024-06-06, FI: 2024-06-03, FR: 2024-06-04, DE: 2024-06-05, GR: 2024-07-15, HU: 2024-06-03, IT: 2024-06-05, LV: 2024-06-21, RO: 2024-06-05, ES: 2024-06-04, NL: 2024-06-28, PL: 2024-06-10, SK: 2024-06-05

Condition(s): Ulcerative Colitis (UC)

Primary endpoint: Treatment-emergent adverse events
Endpoint(s): Clinical response at week 52 and 104, Clinical remission at week 52 and 104, Durable clinical remission at week 52 and 104, Endoscopic remission at week 52 and 104, Histologic remission at week 52 and 104, Corticosteroid-free remission at week 52 and 104 in subjects receiving corticosteroids at randomization of the phase 2 parent study (Study 20170104), Combined endoscopic and histologic remission at week 52 and 104, Symptomatic remission at week 52 and 104, Change from baseline of Study 20170104 in histological score (Geboes) at week 52 and 104

Source: https://euclinicaltrials.eu/ctis-public/view/2023-506046-24-00